EU clinical trial 2023-509352-34-00: An Open-label, Phase 2 Study of ACP-196 in Subjects with Mantle Cell Lymphoma
Protocol code: ACE-LY-004
Sponsor: Acerta Pharma B.V. (Pharmaceutical company). Phase: Therapeutic exploratory (Phase II). Countries: Poland (ended), France (ended).
Therapeutic area(s): Diseases [C] - Neoplasms [C04]
Gender: Female, Male. Age: 18-64 years, 65+ years. Enrolment: 3.
Status: Ended. Start date (EU): 2015-06-18. End date (EU): 2025-11-03. Decision date: 2024-06-04. Results received: No. Last updated: 2025-10-02.
Decision dates by country: FR: 2024-06-04, PL: 2024-06-10

Condition(s): Mantle Cell Lymphoma
Product: Calquence 100 mg hard capsules, Calquence 100 mg film-coated tablets

Primary endpoint: The primary endpoint of the study is the overall response rate (ORR), defined as the proportion of subjects achieving either a partial response (PR) or complete response (CR) according to the Lugano Classification for NHL as assessed by investigators.
Endpoint(s): Efficacy: • duration of response (DOR) • progression-free survival (PFS) • overall survival (OS) • IRC-assessed ORR, DOR and PFS per Lugano Classification, Safety: • frequency and severity of adverse events • frequency of adverse events requiring discontinuation of study drug or dose reductions • effect of acalabrutinib on peripheral T/B/natural killer (NK) cell counts • effect of acalabrutinib on serum immunoglobulin levels, Pharmacokinetics: • plasma pharmacokinetics of acalabrutinib

Source: https://euclinicaltrials.eu/ctis-public/view/2023-509352-34-00